EU clinical trial 2025-522697-37-00: Phase 1/2 Investigation Of Novel Experimental Regimen in Amyotrophic Lateral Sclerosis (PIONEER-ALS): An Open-Label, Uncontrolled, Multicenter Study to Assess the Safety and Tolerability of Two Doses of VTx-002.
Protocol code: VTx-002-01-001
Sponsor: VectorY Therapeutics B.V. (Pharmaceutical company). Phase: Phase I and Phase II (Integrated)- First administration to humans. Countries: Netherlands (ongoing, recruiting), Belgium (authorised, recruitment pending), Spain (ended).
Therapeutic area(s): Diseases [C] - Nervous System Diseases [C10]
Gender: Female, Male. Age: 18-64 years, 65+ years. Enrolment: 4.
Start date (EU): 2026-06-05. Decision date: 2026-03-31. Results received: No. Last updated: 2026-07-16.
Decision dates by country: ES: 2026-04-06, NL: 2026-04-01, BE: 2026-03-31

Condition(s): Amyotrophic Lateral Sclerosis
Product: VTx-002 Diluent, VTx-002, VTx-002

Primary endpoint: Nature, incidence, severity, relatedness, seriousness, and outcome of treatment-emergent adverse events (TEAEs) including: o Laboratory values o Magnetic resonance imaging (MRI) findings o Treatment-induced Peripheral Neuropathy Assessment Scale (TNAS) o Assessment of cellular responses to both the vector and the transgene encoded protein o Columbia Suicide Severity Rating Scale (C-SSRS)
Endpoint(s): Change in revised ALS Functional Rating Scale (ALSFRS-R) over 6 and 12 months, Time to permanent assisted ventilation, or death over 52 weeks, Change in slow vital capacity (SVC) over 6 and 12 months, Survival, Immunogenicity against adeno-associated virus (AAV) capsid

Source: https://euclinicaltrials.eu/ctis-public/view/2025-522697-37-00